EU clinical trial 2024-512104-19-00: Randomized, double-blind, placebo-controlled, multi-centre trial to evaluate the efficacy, safety and tolerability of oral treatment with living bacteria of E. coli DSM 17252 (Symbioflor®2) in patients with diarrhoea-predominant irritable bowel syndrome (IBS-D)
Protocol code: SymSF2
Sponsor: SymbioPharm GmbH (Pharmaceutical company). Phase: Therapeutic use (Phase IV). Countries: Germany (ongoing, recruiting).
Therapeutic area(s): Diseases [C] - Digestive System Diseases [C06]; Diseases [C] - Nutritional and Metabolic Diseases [C18]; Diseases [C] - Immune System Diseases [C20]
Gender: Female, Male. Age: 18-64 years, 65+ years. Enrolment: 422.
Status: Ongoing, recruiting. Start date (EU): 2019-11-19. Decision date: 2024-08-14. Results received: No. Last updated: 2026-06-17.

Condition(s): Irritable Bowel Syndrome
Product: Placebo suspension is identical to Symbioflor®2 liquid formulation in appearance, weight and composition, with the exception that the active ingredient will be omitted. Placebo constitutes are sodium chloride, magnesium sulphate 7H2O, potassium chloride, calcium chloride 2H2O, magnesium chloride 6H2O, and purified water, Symbioflor 2 Tropfen zum Einnehmen, Suspension

Primary endpoint: 1. Response rate measured by Bristol Stool Scale. BSS response is defined as at least 50% reduction in the number of days with at least one stool that has a consistency of 6 or 7 per week compared to baseline for a minimum of 13 of the 26 measurements (i.e. at least 50% improvement of stool consistency during treatment) and 2. Response rate measured by the 11-point numeric rating scale (NRS). Abdominal Pain Intensity response is defined as a decrease in the weekly average of worst abdominal pain
Endpoint(s): Response rate measured by the 7-point IBS Global Assessment of Improvement Scale (IBS-GAI) during the 26 weeks of treatment. IBS-GAI response is defined as at least 50% moderate or substantial improvement during the 26 weeks of treatment • Response rate measured by the 11-point numeric rating scale during the 26 weeks of treatment. Response is defined as ≥30% improvement in Abdominal Pain Intensity weekly response compared to baseline for a minimum of 20 of the 26 measurements (i.e. 75% improvem

Source: https://euclinicaltrials.eu/ctis-public/view/2024-512104-19-00